EU clinical trial 2024-513986-38-00: PAXIPEM : Multicenter phase II study of axitinib +/- pembrolizumab in first line treatment for patients with locally advanced or metastatic papillary renal cell carcinoma (PRCC)
Protocol code: ET21-023
Sponsor: Centre Leon Berard (Hospital/Clinic/Other health care facility). Phase: Therapeutic exploratory (Phase II). Countries: France (ongoing, recruitment ended).
Therapeutic area(s): Diseases [C] - Neoplasms [C04]
Gender: Female, Male. Age: 18-64 years, 65+ years. Enrolment: 72.
Status: Ongoing, recruitment ended. Start date (EU): 2022-06-01. Decision date: 2024-10-02. Results received: No. Last updated: 2026-01-09.

Condition(s): Locally advanced or metastatic papillary cell carcinoma (PRCC)
Product: AXITINIB, KEYTRUDA 25 mg/mL concentrate for solution for infusion

Primary endpoint: Objective response rate (ORR)
Endpoint(s): The duration of response (DOR), The best overall response (BOR),, The progression-free survival (PFS),, The overall survival (OS),, The safety according to NCI CTC-AE v5.

Source: https://euclinicaltrials.eu/ctis-public/view/2024-513986-38-00